EU clinical trial 2026-526209-13-00: A more sustainable perioperative treatment regimen for gastroesophageal cancer —replacing 5-FU with capecitabine within the FLOT regimen
Sponsor: Erasmus Universitair Medisch Centrum Rotterdam (Erasmus MC) (Hospital/Clinic/Other health care facility). Phase: Human Pharmacology (Phase I)- Other. Countries: Netherlands (authorised, recruitment pending).
Therapeutic area(s): Diseases [C] - Neoplasms [C04]
Gender: Female, Male. Age: 18-64 years, 65+ years. Enrolment: 14.
Status: Authorised, recruitment pending. Decision date: 2026-07-21. Results received: No. Last updated: 2026-07-21.

Condition(s): Gastric Cancer, Esophageal cancer
Product: Capecitabine 500 mg film-coated tablets, Capecitabine 150 mg film-coated tablets

Primary endpoint: The MTD will be established using a 3+3 dose escalation design in which the amount of DLTs will determine the MTD (see 6.1 Trial design for a detailed explanation)
Endpoint(s): Assessed by analyzing the AUCs of capecitabine metabolites and comparing them within each patient between the preoperative and postoperative settings. These AUC values will subsequently be used to calculate an AUC ratio, Percentage of patients discontinuing treatment due to treatment-related adverse events, Percentage of patients completing neoadjuvant treatment cycles, Percentage of patients completing adjuvant treatment cycles, Safety of the administered treatment, assessed by: - All treatment-related adverse events (AEs) according to CTCAEv6 - All serious adverse events (SAEs); - All postoperative complications Additionally, AEs preoperatively will be compared to AEs postoperatively.

Source: https://euclinicaltrials.eu/ctis-public/view/2026-526209-13-00